EU clinical trial 2022-502983-19-00: A Phase 2 Open-Label, Multicenter Study to Evaluate Efficacy and Safety of ZN‑c3 in Subjects with High-Grade Serous Ovarian, Fallopian Tube, or Primary Peritoneal Cancer
Protocol code: ZN‑c3-005
Sponsor: K-Group Beta Inc. (Pharmaceutical company). Phase: Therapeutic exploratory (Phase II). Countries: Belgium (ongoing, recruiting), Spain (ongoing, recruiting), Italy (ongoing, recruiting), Poland (ongoing, recruiting), France (ongoing, recruitment ended).
Therapeutic area(s): Diseases [C] - Neoplasms [C04]
Gender: Female. Age: 18-64 years, 65+ years. Enrolment: 137.
Start date (EU): 2025-07-31. Decision date: 2024-02-02. Results received: No. Last updated: 2026-07-02.
Decision dates by country: BE: 2024-02-05, IT: 2024-02-06, FR: 2024-03-22, PL: 2024-02-05, ES: 2024-02-05

Condition(s): High-Grade Serous Ovarian, Fallopian Tube, or Primary Peritoneal Cancer
Product: ONDANSETRON, Azenosertib (also known as ZN-c3; KP-2638), OLANZAPINE, APREPITANT, GRANISETRON, Akynzeo 300 mg/0.5 mg hard capsules, Azenosertib (also known as ZN-c3; KP-2638), DEXAMETHASONE, Azenosertib (also known as ZN-c3; KP-2638)

Primary endpoint: Part 1b: • Frequency and severity of TEAEs • Incidence of dose interruptions, dose reductions, and permanent discontinuations of ZN-c3 azenosertib due to related TEAEs, Part 2a: Independent primary endpoints: ORR as defined by RECIST v1.1 and as assessed by the Investigator in subjects with centrally determined cyclin E1-positive status • Frequency and severity of TEAEs, Part 2b and 2c: • ORR as defined by RECIST v1.1 and as assessed by the Investigator in subjects with centrally determined cyclin E1-positive status in the following sequence and cohorts: 1. Part 2a and Part 2b 2. Parts 2a, 2b, and 2c
Endpoint(s): Part 1b: • Summarized by cohort and overall: o ORR, DOR, TTR, PFS, and CBR as defined by RECIST v1.1 and as assessed by ICR and the Investigator o OS o CA-125 response by GCIG criteria • Plasma concentrations of azenosertib, Part 2a: • DOR, TTR, PFS, and CBR as defined by RECIST v1.1 and as assessed by the Investigator • OS • CA-125 response by GCIG criteria • ORR and DOR as defined by RECIST v1.1 and as assessed by the Investigator • Systemic plasma concentrations of azenosertib (and applicable metabolites), Part 2b and 2c: • Frequency and severity of TEAEs • DOR, TTR, PFS, and CBR as defined by RECIST v1.1 as assessed by the Investigator • ORR, DOR, TTR, PFS, and CBR as defined by RECIST v1.1 as assessed by ICR • OS • CA-125 response by GCIG criteria • ORR and DOR as defined by RECIST v1.1 as assessed by the Investigator

Source: https://euclinicaltrials.eu/ctis-public/view/2022-502983-19-00